EU clinical trial 2023-508694-80-01: Effect of Saccharomyces boulardii CNCM I-745 on gut microbiota in patients undergoing antibiotic therapy (in the context of erythema migrans (early skin form of Lyme borreliosis)
Protocol code: Sb 241
Sponsor: Biocodex (Pharmaceutical company). Phase: Therapeutic use (Phase IV). Countries: Slovenia (ongoing, recruiting), Czechia (ongoing, recruiting), Lithuania (ongoing, recruiting), Slovakia (ongoing, recruiting).
Therapeutic area(s): Diseases [C] - Digestive System Diseases [C06]
Gender: Female, Male. Age: 18-64 years, 65+ years. Enrolment: 140.
Status: Ongoing, recruiting. Start date (EU): 2024-06-18. Decision date: 2024-03-29. Results received: No. Last updated: 2026-06-19.
Decision dates by country: LT: 2025-07-16, CZ: 2025-07-16, SI: 2024-03-29, SK: 2025-07-16

Condition(s): Patients undergoing antibiotic therapy (in the context of erythema migrans (early skin form of Lyme borreliosis))
Product: Enterol 250 mg, gélules, Hiconcil 500 mg trde kapsule, Matched Placebo will consist in caspules similar to the 250 mg capsules of the Saccharomyces boulardii CNCM-I-745 but with no active ingredient

Primary endpoint: Changes observed: - in bacterial and fungal taxonomy (alpha diversity, Shanon index) - in beta diversity metrics (such as Bray Curtis dissimilarity, Jaccard distance, Unifrac...). Analyses will be performed by treatment group and at each assessment time.
Endpoint(s): Incidence of AAD (The number of AAD episodes that occurred during the treatment period) will be assessed using the Bristol Stool Form Scale (BSFS) recorded daily. Analyses will be performed by treatment group, The proportion of patients with at least one AAD episode will be compared between the two treatment groups, Time frame in hours up to the time of the last liquid or loose stool (defined as types 6 or 7 on BSFS) followed by the first 24-hour period with stool consistency improvement (no liquid or loose stool), as recorded by the patients in the stool diary or as collected by the investigator, the average number of stools per week, the average number of unformed or formed (according to the score) stools per week, duration of number of days with diarrhea, number of episodes of diarrhea., Changes from baseline of the GSRS score (total score) and diarrhea sub-scores will be compared weekly between the treatment groups., Safety will be evaluated based on recorded adverse events (number of events and number of participants with at least one event), vital signs, and physical examination (quantitative statistics at each assessment time and changes from baseline).

Source: https://euclinicaltrials.eu/ctis-public/view/2023-508694-80-01